EU clinical trial 2022-502332-39-00: Long-term neuropsychologic outcome of pre-emptive mTOR inhibitor treatment in children with tuberous sclerosis complex (TSC) under 4 months of age (PROTECT)
Protocol code: PROTECT
Sponsor: Heidelberg University Hospital AöR (Hospital/Clinic/Other health care facility). Phase: Therapeutic exploratory (Phase II). Countries: Germany (ongoing, recruiting), Austria (ongoing, recruiting).
Therapeutic area(s): Diseases [C] - Congenital, Hereditary, and Neonatal Diseases and Abnormalities [C16]; Diseases [C] - Nervous System Diseases [C10]
Gender: Female, Male. Age: 0-17 years. Enrolment: 64.
Status: Ongoing, recruiting. Start date (EU): 2023-11-15. Decision date: 2023-09-20. Results received: No. Last updated: 2026-06-08.
Decision dates by country: AT: 2025-03-17, DE: 2023-09-20

Condition(s): Tuberous sclerosis complex (TSC)
Product: VIGABATRIN, VALPROIC ACID, CARBAMAZEPINE, SODIUM VALPROATE, VERAPAMIL, PREDNISOLONE, Rapamune 1 mg/mL oral solution, OXCARBAZEPINE, PHENOBARBITAL, MIDAZOLAM HYDROCHLORIDE, PROPRANOLOL, TETRACOSACTIDE, PROPRANOLOL HYDROCHLORIDE, DIAZEPAM

Primary endpoint: Neuropsychologic outcome at 24 months of age assessed by rater blinded neuropsychologic testing measured by the cognitive scale on the Bayley Scales of Infant and Toddler Development III (BSID-III) compared with Standard of Care (SOC) alone.
Endpoint(s): Neuropsychologic outcome at 12 months of age assessed by rater blinded neuropsychologic testing using the cognitive scale on the BSID-III in both groups. Cognitive impairment will be defined as BSID-III cognitive scale score <70 similar to the EPISTOP trial., Adaptive behaviour assessed by the Vineland Adaptive Behaviour Scales (VABS-3; digital) at the age of 12 months and 24 months., Evidence for autism spectrum disorder measured at 12 months and 24 months of age by the Autism Diagnostic Observation Schedule (ADOS-2). Suspicion of autism spectrum disorder will be defined as ADOS >12, similar to the EPISTOP trial., Evidence for autism spectrum disorder measured by the Modified Checklist for Autism in Toddlers revised (M-CHAT-R/F)., TSC-associated Neuropsychiatric Disorders (TAND) severity assessed by the TAND-L Checklist (German version) at 12 and 24 months., Assessment of seizure frequency and the occurrence/severity of infantile spasms (IS) measured by seizure diaries, care giver questionnaires and electroencephalogram (EEG) recordings., Reduction of number and size of cardiac rhabdomyoma and arrhythmia (if present)., Reduction of cerebral tumor number and size on cranial magnetic resonance imaging (cMRI) (if present), Adverse events (AE), serious adverse events (SAE) and Adverse Events of Special Interest (AESI), assessed by the Common Terminology Criteria of Adverse Events (CTCAE, Version 5.0, or most recent version)., Assessment of laboratory data and vital signs., Assessment of EEG recordings for the occurrence of hypsarrhythmia and epileptiform discharges., Renal changes in abdominal sonography: Volume and size of angiomyolipomas (if present), kidney size, renal pelvis dilation, echogenicity.

Source: https://euclinicaltrials.eu/ctis-public/view/2022-502332-39-00